EU clinical trial 2025-523276-23-00: A Phase I/II open label study of DJI136, a DLL3-targeted CAR-T therapy, in adult patients with ES-SCLC
Protocol code: CDJI136A12101
Sponsor: Novartis Pharma AG (Pharmaceutical company). Phase: Phase I and Phase II (Integrated)- First administration to humans. Countries: Spain (authorised, recruitment pending), France (authorised, recruitment pending).
Therapeutic area(s): Diseases [C] - Neoplasms [C04]
Gender: Female, Male. Age: 18-64 years, 65+ years. Enrolment: 25.
Status: Authorised, recruitment pending. Decision date: 2026-05-27. Results received: No. Last updated: 2026-06-01.
Decision dates by country: FR: 2026-05-27, ES: 2026-06-01

Condition(s): Extensive stage small cell lung cancer
Product: BENDAMUSTINE HYDROCHLORIDE, CYCLOPHOSPHAMIDE, DJI136, FLUDARABINE PHOSPHATE, TOCILIZUMAB

Primary endpoint: All study parts: Incidence and severity of AEs, SAEs, changes in laboratory values, vital signs, and ECGs, Incidence and nature of dose limiting toxicity (DLTs), Phase II Group A: Overall response rate (ORR) as per RECIST v1.1
Endpoint(s): Phase I Part A and Phase II: ORR, disease control rate (DCR), duration of response (DoR), and progression free survival (PFS) as per RECIST v1.1, Phase II Group A: DCR, DoR, and PFS as per RECIST v1.1, Phase I Part A and Phase II: Summary of CAR transgene levels by qPCR in peripheral blood (and other tissue, if available), and cellular kinetic parameters (Cmax, Tmax, AUC, Clast, and Tlast) from peripheral blood profile samples by time point

Source: https://euclinicaltrials.eu/ctis-public/view/2025-523276-23-00